EU clinical trial 2023-504553-12-01: Aspirin to prevent cardiovascular events in patients with community-acquired pneumonia or influenza
Sponsor: Amsterdam UMC (Hospital/Clinic/Other health care facility). Phase: Therapeutic use (Phase IV). Countries: Netherlands (ended).
Therapeutic area(s): Diseases [C] - Respiratory Tract Diseases [C08]; Diseases [C] - Cardiovascular Diseases [C14]
Gender: Female, Male. Age: 18-64 years, 65+ years. Enrolment: 760.
Status: Ended. Start date (EU): 2023-12-27. End date (EU): 2026-06-30. Decision date: 2023-09-15. Results received: No. Last updated: 2025-10-09.

Condition(s): Influenza, Myocardial infarction, Pneumonia
Product: Pantoprazol Teva 20 mg maagsapresistente tabletten, PLACEBO, Acetylsalicylzuur Cardio Teva 80 mg

Primary endpoint: Incidence of an acute coronary syndrome (ACS) up to day 180
Endpoint(s): Incidence of 4-point MACE (nonfatal stroke, nonfatal myocardial infarction, cardiovascular death and coronary revascularization) up to day 180, Incidence of major bleeding complication and clinically relevant non-major bleeding up to day 90, Length of hospital stay, Mortality at day 90 and day 180, Societal costs up to day 180 measured with IMCQ and IPCQ, Health-related quality of life measured with the EQ-5D-5L

Source: https://euclinicaltrials.eu/ctis-public/view/2023-504553-12-01